EU clinical trial 2025-523435-18-00: Colchicine for the Reduction of Dependency and Vascular Events after an Acute Intracerebral Hemorrhage (CoVasc-ICH2)
Protocol code: CoVasc-ICH2
Sponsor: Hamilton Health Sciences Corporation, PHRI Population Health Research Institute International (Hospital/Clinic/Other health care facility, Laboratory/Research/Testing facility). Phase: Therapeutic confirmatory (Phase III). Countries: Spain (authorised, recruitment pending), Belgium (authorised, recruitment pending).
Therapeutic area(s): Diseases [C] - Cardiovascular Diseases [C14]
Gender: Female, Male. Age: 18-64 years, 65+ years. Enrolment: 312.
Status: Authorised, recruitment pending. Decision date: 2026-07-22. Results received: No. Last updated: 2026-07-28.
Decision dates by country: BE: 2026-07-28, ES: 2026-07-22

Condition(s): Major cardiovascular events (MACE), spontaneous intracerebral hemorrhage
Product: Colchicine Aspire 0.5 mg Tablets, Placebo 0.5mg tablet

Primary endpoint: Hierarchical composite endpoint (HCE) that combines MACE and dependency, which includes the following components:, a. time-to first stroke (ischemic, hemorrhagic or undefined), b. time-to cardiovascular death, c. dependency, defined as modified Rankin Scale scores (mRS) between 3 and 5, at 6 months from randomization, d. time-to first myocardial infarction, e. time-to first revascularization procedure for coronary, carotid, or peripheral arterial disease
Endpoint(s): Functional outcome at 6-months, assessed with the modified Rankin Score (mRS) scale, Cognitive outcome at the end of study, assessed by the telephone Montreal Cognitive Assessment (T-MoCA) and the telephone Mental Alternation Test (t-MAT), Quality of life at the end of study, assessed with the EQ-5D-5L [global questionnaire], Disabling or fatal stroke during follow-ups, assessed with the Modified Rankin Scale (mRS) scale

Source: https://euclinicaltrials.eu/ctis-public/view/2025-523435-18-00